EU clinical trial 2024-516789-13-00: WIthdrawal of DUpilumab in Severe Asthma : a randomised non-inferiority-controlled trial
Protocol code: RC31/24-0325
Sponsor: Centre Hospitalier Universitaire De Toulouse (Hospital/Clinic/Other health care facility). Phase: Therapeutic use (Phase IV). Countries: France (ongoing, recruiting).
Therapeutic area(s): Diseases [C] - Respiratory Tract Diseases [C08]
Gender: Female, Male. Age: 18-64 years, 65+ years. Enrolment: 205.
Status: Ongoing, recruiting. Start date (EU): 2025-12-15. Decision date: 2025-01-30. Results received: No. Last updated: 2026-02-11.

Condition(s): Severe asthma
Product: Dupixent 300 mg solution for injection in pre-filled syringe

Primary endpoint: The proportion of patients with strategy failure defined as patients with an annualised number of asthma exacerbations ≥ 2 and/or resumption of dupilumab or switch to another biologic within 24 months following randomisation
Endpoint(s): To compare stopping dupilumab with its continuation regarding: a) the change in the asthma control test (ACT) score at 6, 12 and 24 months compared to baseline b) the time between baseline to loss of control defined with a reduction of 5 points or more on ACT score (compared to baseline) c) the time between baseline to the first exacerbation d) the number of exacerbations within 24 months e) the proportion of patients with ≥ 1 exacerbation and ≥ 1 severe exacerbation at 6, 12 and 24 months, The proportion of patients with resumption of dupilumab in the interventional group (stopping dupilumab) at 6, 12 and 24 months, The proportion of patients with AE or SAE in both groups

Source: https://euclinicaltrials.eu/ctis-public/view/2024-516789-13-00